EU clinical trial 2023-505897-13-00: Double-blind, randomised clinical study comparing efficacy and safety of Ivermectin 10 mg/g Cream (Test) vs. Soolantra® 10 mg/g Cream (Reference) vs. Vehicle in patients with papulopustular rosacea
Protocol code: 23-03/Iver-C
Sponsor: Dermapharm AG (Pharmaceutical company). Phase: Therapeutic confirmatory (Phase III). Countries: Germany (ongoing, recruiting).
Therapeutic area(s): Diseases [C] - Skin and Connective Tissue Diseases [C17]
Gender: Female, Male. Age: 18-64 years, 65+ years. Enrolment: 726.
Status: Ongoing, recruiting. Start date (EU): 2024-12-02. Decision date: 2024-11-13. Results received: No. Last updated: 2026-04-02.
Decision dates by country: DE: 2024-12-13

Condition(s): Papulopustular Rosacea
Product: Vehicle to Test Product, Ivermectin Cream, Soolantra 10 mg/g Creme

Primary endpoint: Percent change from baseline (Visit 1) to Visit 8 (EoT) assessed by the inflammatory lesion (papules and pustules) count
Endpoint(s): Proportion of subjects with a clinical response of “success”, i.e. the percentage of subjects with an IGA score of “0 = Clear” or “1 = Almost Clear”, at Day 84 ± 4., Percent change and absolute change in inflammatory lesion (papules and pustules) count between baseline (Visit 1) and Visit 2, Visit 3, Visit 4, Visit 5, Visit 6, Visit 7, respectively., Change in the assessment of facial erythema between baseline (Visit 1) and Visit 2, Visit 3, Visit 4, Visit 5, Visit 6, Visit 7, and Visit 8, respectively., Change of the Investigator`s Global Assessment (IGA) between baseline (Visit 1) and Visit 2, Visit 3, Visit 4, Visit 5, Visit 6, Visit 7 and Visit 8, respectively. Changes will be calculated as baseline- follow-up., Evaluation of the overall therapeutic success by the investigator and patient at day 84 ± 4 (EOT)., Incidence of adverse events (AEs) during the course of the study, Evaluation of tolerability by the investigator and by the patient from Visit 2 to Visit 8 (EOT)

Source: https://euclinicaltrials.eu/ctis-public/view/2023-505897-13-00